EU clinical trial 2023-504880-18-00: A phase 1B of crizotinib either in combination or as single agent in pediatric patients with ALK, ROS1 or MET positive malignancies
Protocol code: CRISP ITCC-053
Sponsor: Erasmus Universitair Medisch Centrum Rotterdam (Erasmus MC) (Hospital/Clinic/Other health care facility). Phase: Phase I and Phase II (Integrated)- Other. Countries: Germany (ongoing, recruiting), Italy (ongoing, recruiting), France (ongoing, recruiting), Spain (ongoing, recruiting), Netherlands (ongoing, recruiting), Denmark (authorised, recruiting), Finland (ongoing, recruiting), Norway (authorised, recruiting), Slovakia (authorised, recruitment pending).
Therapeutic area(s): Diseases [C] - Neoplasms [C04]
Gender: Female, Male. Age: 0-17 years, 18-64 years. Enrolment: 72.
Start date (EU): 2018-04-18. Decision date: 2024-02-27. Results received: No. Last updated: 2026-05-07.
Decision dates by country: NL: 2024-02-27, FR: 2024-03-04, NO: 2025-11-14, DK: 2024-02-28, SK: 2026-04-27, DE: 2024-02-28, ES: 2024-03-01, IT: 2024-03-01, FI: 2025-07-15

Condition(s): Neuroblastoma (NBL), Rhabdomyosarcoma (RMS), Inflammatory Myofibroblastic Tumors (IMT), Other ALK/ROS1/MET-positive malignancies, Anaplastic Large Cell Lymphoma (ALCL)
Product: CRIZOTINIB, CRIZOTINIB, XALKORI 200 mg hard capsules, CRIZOTINIB, CRIZOTINIB, CRIZOTINIB, XALKORI 250 mg hard capsules, Torisel 30 mg concentrate and solvent for solution for infusion

Primary endpoint: Dose Limiting Toxicities (DLT) during the first cycle of crizotinib, in combination with temsirolimus for stratum 2, overall response rate for stratum 1b and 3.
Endpoint(s): Stratum 2 only: Overall response rate defined as the number of patients achieving complete and partial responses by disease after 2 courses (8 weeks), Best overall response rate defined as best reported overall lesions response at different evaluation time points from the start of study treatment until disease progression, Plasma concentration time profiles, PK parameters for crizotinib and for temsirolimus, Progression-free survival (PFS), Overall survival

Source: https://euclinicaltrials.eu/ctis-public/view/2023-504880-18-00